EU clinical trial 2022-501135-16-00: Comparative Bioavailability and Bioequivalence of Oxazepam 50 mg Orodispersible Tablets (Test) Versus Seresta® 50 mg Tablets (Reference): A Single-Dose, Open-Label, Randomized, Two-Sequence, Two-Treatment, Two-Period Crossover Study in Healthy Subjects
Protocol code: LESVIOXA/22/BQ-3
Sponsor: Laboratorios Lesvi S.L. (Pharmaceutical company). Phase: Human Pharmacology (Phase I)- Bioequivalence Study. Countries: Portugal (ended).
Therapeutic area(s): Diseases [C] - Nervous System Diseases [C10]
Gender: Female, Male. Age: 18-64 years. Enrolment: 28.
Status: Ended. Start date (EU): 2022-12-26. End date (EU): 2023-01-27. Decision date: 2022-10-25. Results received: Yes. Last updated: 2022-10-25.

Condition(s): No medical condition is being investigated. This is a comparative bioavailability study.
Product: SERESTA 50 mg, comprimé sécable, Oxazepam

Primary endpoint: Cmax and AUC0-t of oxazepam will be the primary pharmacokinetic parameters.
Endpoint(s): Safety will be evaluated through the assessment of adverse events (AEs), ECG, vital signs, and clinical laboratory tests., Palatability of test product will be assessed approximately 30 seconds and 5 minutes after placing the Oral Dispersible Tablet on the tongue.

Source: https://euclinicaltrials.eu/ctis-public/view/2022-501135-16-00